EU clinical trial 2023-507066-91-00: A Phase 1, open label, randomized, 2-sequence, 2-period, crossover, single center study to evaluate the pharmacokinetics of follitropin alfa from 2 manufacturing processes, administered as a single subcutaneous 450 IU dose to pituitary-suppressed healthy premenopausal female participants.
Protocol code: MS700623_0061
Sponsor: Merck Healthcare KGaA (Pharmaceutical company). Phase: Human Pharmacology (Phase I)- Other. Countries: Netherlands (ended).
Therapeutic area(s): Diseases [C] - Hormonal diseases [C19]
Gender: Female. Age: 18-64 years. Enrolment: 14.
Status: Ended. Start date (EU): 2024-03-19. End date (EU): 2024-10-01. Decision date: 2024-02-15. Results received: No. Last updated: 2024-02-15.

Condition(s): Infertility

Source: https://euclinicaltrials.eu/ctis-public/view/2023-507066-91-00